EU clinical trial 2025-524312-11-00: Everolimus bAsed caLcineurin inhibiTor frEe immunosuppRession oNe year AfTer lIver transplantatiON (ALTERNATION) – a randomized, prospective, multicenter, open-label, controlled phase III trial
Protocol code: ALTERNATION
Sponsor: Medizinische Hochschule Hannover (Educational Institution). Phase: Therapeutic confirmatory (Phase III). Countries: Germany (authorised, recruitment pending).
Therapeutic area(s): Analytical, Diagnostic and Therapeutic Techniques and Equipment [E] - Therapeutics [E02]
Gender: Female, Male. Age: 18-64 years, 65+ years. Enrolment: 150.
Status: Authorised, recruitment pending. Decision date: 2026-06-26. Results received: No. Last updated: 2026-06-26.

Condition(s): Patients after the first year following liver transplantation
Product: EVEROLIMUS, TACROLIMUS, CICLOSPORIN, MYCOPHENOLATE MOFETIL

Primary endpoint: Change in estimated glomerular filtration rate (eGFR (ml/min)) from baseline to 14 months after randomization – eGFR will be calculated using the CKD-EPI Creatinine equation according to the national kidney foundation, 2021.(1)
Endpoint(s): Biopsy-proven acute liver graft rejection or liver graft loss (whichever occurs first) until month 14. Biopsy proven acute rejection (BPAR) (yes/no) is defined as liver enzyme elevation above 2xULN and histological criteria according to the most recent BANFF consensus.(2), Change in estimated glomerular filtration rate (eGFR (ml/min)) from baseline to end of follow-up (38 months), Biopsy- proven acute liver graft rejection or liver graft loss (whichever occurs first) until month 38, Progression of chronic kidney disease to stage 4, 5 or requirement for renal replacement therapy (yes/no), Incidence of liver-related mortality (yes/no), Progression of subclinical graft injury (fibrosis) at rebiopsy at month 14 and end of follow-up, where progression in the svLBx is defined as reaching histological exclusion criteria from baseline biopsy (≥ 2 points), Progression of subclinical inflammation at rebiopsy at month 14 (yes/no) and end of follow-up (yes/no), where inflammation in the svLBx is defined as reaching exclusion criteria from baseline biopsy (≥ 2 points in any subscore), Quality of life: change from baseline to months 14 and end of follow-up (measured with PROMIS and SF-36), De novo development of donor specific HLA antibodies (yes/no), Increase in liver stiffness above 8,4 kPa (yes/no), Incidence of malignancy (yes/no), Occurrence of infections requiring medical intervention or hospitalization (yes/no), New onset of comorbidities including hypertension (yes/no), dyslipoproteinemia (yes/no) and diabetes mellitus (yes/no)

Source: https://euclinicaltrials.eu/ctis-public/view/2025-524312-11-00